EU clinical trial 2025-525006-37-00: THE ROLE OF PANCREATIC STONE PROTEIN (PSP) AND PSP-GUIDED EARLY MEROPENEM TREATMENT TO MITIGATE SEPSIS RISK AT THE EMERGENCY DEPARTMENT: THE PROMISE DOUBLE BLIND, PHASE III, RANDOMIZED CONTROLLED CLINICAL TRIAL
Protocol code: PROMISE
Sponsor: Elliniko Institouto Meletis Tis Sipsis (Laboratory/Research/Testing facility). Phase: Therapeutic confirmatory (Phase III). Countries: Greece (authorised, recruitment pending).
Therapeutic area(s): Diseases [C] - Pathological Conditions, Signs and Symptoms [C23]; Analytical, Diagnostic and Therapeutic Techniques and Equipment [E] - Therapeutics [E02]
Gender: Female, Male. Age: 18-64 years, 65+ years. Enrolment: 398.
Status: Authorised, recruitment pending. Decision date: 2026-04-29. Results received: No. Last updated: 2026-07-30.

Condition(s): Infection and sepsis
Product: Meronem 1g κόνις για ενέσιμο διάλυμα ή διάλυμα προς έγχυση, Sodium Chloride 0,9%

Primary endpoint: The primary endpoint of this study is 28-day mortality, defined as death from any cause occurring within 28 days after randomization. The aim is to evaluate if early administration of antibiotics guided by early sepsis detection with the device under investigation is associated with a reduction in short-term mortality compared to the control group. Survival is censored at day 28 since this is globally recognized as the survival censoring point in all sepsis trials.
Endpoint(s): The key secondary endpoint is the progression into organ dysfunction defined as increases of total SOFA-2 score by 2 or more points the first 24 hours. The aim is to evaluate if early administration of antibiotics guided by early sepsis detection with the device under investigation is associated with a reduction in progression into organ dysfunction compared to the control group., Comparative changes of the total SOFA-2 scores by the first 48 and 96 hours., Time to stop of antibiotics (defined as treatment started at the discretion of the attending physicians), Duration of hospitalization, Time to hospital discharge alive, 90-day mortality, Kinetics of PSP over-time and per type of infection, Rate of resistant fecal flora, Primary endpoint, key secondary endpoint and all secondary endpoints for patients classified into infections after adjudication

Source: https://euclinicaltrials.eu/ctis-public/view/2025-525006-37-00